EU clinical trial 2022-500599-79-00: An Investigator Initiated, descriptive, proof-of-concept, open-label pilot study targeting the tumor microenvironment and skin barrier deficiency through JAK1/3 inhibition
Sponsor: Aarhus University Hospital (Hospital/Clinic/Other health care facility). Phase: Therapeutic exploratory (Phase II). Countries: Denmark (ended).
Therapeutic area(s): Diseases [C] - Skin and Connective Tissue Diseases [C17]; Analytical, Diagnostic and Therapeutic Techniques and Equipment [E] - Therapeutics [E02]; Diseases [C] - Immune System Diseases [C20]
Gender: Female, Male. Age: 18-64 years, 65+ years. Enrolment: 15.
Status: Ended. Start date (EU): 2023-01-10. End date (EU): 2025-08-06. Decision date: 2022-07-08. Results received: Yes. Last updated: 2024-02-14.

Condition(s): Mycosis Fungoides
Product: XELJANZ 10 mg film-coated tablets

Primary endpoint: • To evaluate complete response (CR), partial response (PR), stable disease (SD) or progressive disease (PD) and the overall response rate to treatment with Xeljanz.

Source: https://euclinicaltrials.eu/ctis-public/view/2022-500599-79-00